EU clinical trial 2024-512632-30-00: A prospective, open-label, genotype-match controlled, multicenter clinical trial to investigate the efficacy and safety of intra-amniotic ER004 as a prenatal treatment for male subjects with X-linked hypohidrotic ectodermal dysplasia (XLHED)
Protocol code: EDELIFE
Sponsor: Pierre Fabre Medicament, Fondation EspeRare (Pharmaceutical company, Patient organisation/association). Phase: Therapeutic exploratory (Phase II). Countries: Italy (ongoing, recruiting), Spain (ongoing, recruiting), France (ongoing, recruiting), Germany (ongoing, recruiting).
Therapeutic area(s): Diseases [C] - Congenital, Hereditary, and Neonatal Diseases and Abnormalities [C16]
Gender: Male. Age: In utero. Enrolment: 11.
Status: Ongoing, recruiting. Start date (EU): 2021-12-02. Decision date: 2024-06-11. Results received: No. Last updated: 2026-04-23.
Decision dates by country: IT: 2024-06-17, ES: 2024-06-11, FR: 2024-06-11, DE: 2024-06-14

Condition(s): X-linked hypohidrotic ectodermal dysplasia (XLHED)
Product: ER004

Primary endpoint: Mean sweat volume collected on both forearms after local stimulation with pilocarpine (pilocarpine-induced sweating).
Endpoint(s): Mean sweat pore density (number/cm2) determined by direct visualization with a VivaScope® at 6 months of age (V8) at 2 different sites on the soles of the feet, Dental development evaluated by the number of erupted teeth and tooth buds (palpable alveolar structures in the alveolar ridge) as determined by oral examination at 6 months of age (V8), Mean sweat volume on both forearms measured from a pilocarpineinduced sweat test (at other timepoints than 6 months)., Sweat pore density (at other timepoints than 6 months)., Dentition (at other timepoints than 6 months)., Dry eye, Salivation assessment, Number of XLHED related hospitalizations, Assessment of eczema, Safety and tolerability assessments, Health-related quality of life assessments

Source: https://euclinicaltrials.eu/ctis-public/view/2024-512632-30-00